EU clinical trial 2023-504298-19-00: A randomized, double-blind, placebo-controlled study to evaluate the efficacy and safety deucravacitinib in patients with chronic hand eczema
Protocol code: DECIDE
Sponsor: Charite Universitaetsmedizin Berlin KöR (Hospital/Clinic/Other health care facility). Phase: Therapeutic exploratory (Phase II). Countries: Germany (ended).
Therapeutic area(s): Diseases [C] - Skin and Connective Tissue Diseases [C17]
Gender: Female, Male. Age: 18-64 years. Enrolment: 57.
Status: Ended. Start date (EU): 2024-07-18. End date (EU): 2025-11-07. Decision date: 2023-11-09. Results received: No. Last updated: 2025-02-11.

Condition(s): Chronic Hand Eczema
Product: Matching placebo to IMP, SOTYKTU 6 mg film-coated tablets

Primary endpoint: Therapeutic efficacy of deucravacitinib defined as the percentage of patients achieving a clinical response (Investigator Global Assessment 0 or 1) with ≥ 2-point improvement in IGA for patients with chronic hand eczema at week 16
Endpoint(s): Participant self-assessment (PSA) [Time Frame: Baseline, week 2, 4, 6, 8, 12 and 16], Quality of Life in Hand Eczema Questionnaire (QOLHEQ) [Time Frame: Baseline; Week 4, 8, 16], Hand eczema severity index (HECSI) [Time Frame: Baseline; Week 4, 8, 16], Evaluation of safety in terms of number of AE and lab parameters, Change in skin physiology from baseline to week 16, Change in histology, in expression of skin barrier proteins, expression of cytokines, in extent of immune cells in skin biopsies, and the transcriptome from baseline to week 16

Source: https://euclinicaltrials.eu/ctis-public/view/2023-504298-19-00